EU clinical trial 2024-516477-73-00: A Phase 1b Dose Escalation Study of Cabozantinib (XL184) Administered Alone or in Combination with Atezolizumab to Subjects with Locally Advanced or Metastatic Solid Tumors
Protocol code: XL184-021
Sponsor: Exelixis Inc. (Pharmaceutical company). Phase: Human Pharmacology (Phase I)- Other. Countries: Spain (ongoing, recruitment ended), France (ended).
Therapeutic area(s): Diseases [C] - Neoplasms [C04]
Gender: Female, Male. Age: 18-64 years, 65+ years. Enrolment: 320.
Start date (EU): 2018-03-07. Decision date: 2024-09-16. Results received: No. Last updated: 2025-05-23.
Decision dates by country: FR: 2024-09-19, ES: 2024-09-16

Condition(s): Bladder cancer and kidney cancer

Source: https://euclinicaltrials.eu/ctis-public/view/2024-516477-73-00